EU clinical trial 2022-502432-39-00: ION356-CS1: A Phase 1b Study to Evaluate the Safety, Pharmacokinetics, and Pharmacodynamics of Intrathecally Administered ION356 in Patients with Pelizaeus-Merzbacher Disease
Protocol code: ION356-CS1
Sponsor: Ionis Pharmaceuticals Inc. (Pharmaceutical company). Phase: Human Pharmacology (Phase I)- First administration to humans. Countries: Netherlands (ongoing, recruiting), Germany (ongoing, recruiting), France (ongoing, recruiting).
Therapeutic area(s): Diseases [C] - Nervous System Diseases [C10]; Diseases [C] - Congenital, Hereditary, and Neonatal Diseases and Abnormalities [C16]
Gender: Male. Age: 0-17 years. Enrolment: 33.
Status: Ongoing, recruiting. Start date (EU): 2024-04-10. Decision date: 2023-11-02. Results received: No. Last updated: 2026-03-30.
Decision dates by country: NL: 2023-11-02, DE: 2023-11-03, FR: 2023-11-06

Condition(s): Pelizaeus-Merzbacher Disease
Product: ION356

Primary endpoint: 1. Incidence of treatment-emergent adverse events (TEAEs) and serious adverse events (SAEs) from Day 1 to the final study visit over the course of the study • Incidence and frequency of TEAEs and SAEs • Change from Baseline over the course of the study in the following: − Laboratory assessments including clinical chemistry, hematology and coagulation in plasma/serum; urinalysis, and cerebrospinal fluid (CSF) safety panel − Neurological exam and vital signs − ECG − Concomitant medication use
Endpoint(s): 1. ION356 concentrations in plasma and CSF over the course of the study • Maximum plasma concentration (Cmax), area under the concentration-time curve (AUC), elimination half-life (t½), and trough (pre-dose) and post-treatment ION356 concentrations, where appropriate • ION356 trough (pre-dose) and post-treatment concentrations in CSF • ION356 excretion in urine, percent of dose excreted, and renal clearance

Source: https://euclinicaltrials.eu/ctis-public/view/2022-502432-39-00